EU clinical trial 2022-503012-16-00: TAK-330-3001 - A Phase 3, Prospective, Randomized, Open-label, Adaptive Group Sequential, Multicenter Trial with Blinded Endpoint Assessment to Evaluate the Efficacy and Safety of TAK-330 for the Reversal of Direct Oral Factor Xa Inhibitor-induced Anticoagulation in Patients Requiring Urgent Surgery/Invasive Procedure
Protocol code: TAK-330-3001
Sponsor: Takeda Development Center Americas Inc. (Pharmaceutical company). Phase: Therapeutic confirmatory (Phase III). Countries: Netherlands (ended), Spain (ongoing, recruiting), Austria (ongoing, recruiting), Germany (ongoing, recruiting), France (ongoing, recruiting), Belgium (ongoing, recruiting), Czechia (ongoing, recruiting), Greece (ongoing, recruiting), Hungary (ongoing, recruiting), Portugal (ongoing, recruiting), Poland (ongoing, recruiting).
Therapeutic area(s): Diseases [C] - Hemic and Lymphatic Diseases [C15]
Gender: Female, Male. Age: 18-64 years, 65+ years. Enrolment: 224.
Start date (EU): 2022-07-20. Decision date: 2023-07-04. Results received: No. Last updated: 2026-01-27.
Decision dates by country: NL: 2023-07-10, PT: 2024-04-19, HU: 2024-04-19, ES: 2023-07-04, BE: 2023-08-07, AT: 2023-07-10, CZ: 2024-04-16, PL: 2024-04-18, FR: 2023-07-06, DE: 2023-07-04, GR: 2024-04-19

Condition(s): Patients on treatment with Factor Xa Inhibitor needing for an urgent intervention associated with a high risk of bleeding.
Product: PROTHROMPLEX TOTAL®, COAGULATION FACTOR IX, II, VII AND X IN COMBINATION

Primary endpoint: Occurrence of intraoperative effective hemostasis assessed at the end of the surgery/invasive procedure based on the assessment of the PI, the surgeon or a qualified member of the surgical team using the Four Point Intraoperative Hemostatic Efficacy Scale (Section 8.2.2.1).
Endpoint(s): Key Secondary Endpoint: Occurrence of postoperative effective hemostasis assessed at 24 hours after the end of investigational product infusion (TAK-330 or comparator 4F-PCC) based on the assessment of the PI, the surgeon or a qualified member of the surgical team using the Four Point Postoperative Hemostatic Efficacy Scale (Section 8.2.2.1)., • Occurrence of intraoperative effective hemostasis assessed at the end of the surgery/invasive procedure based on the assessment of the PI, the surgeon or a qualified member of the surgical team using the Hemostatic Efficacy Rating Algorithm (Section 8.2.2.2)., • Usage of blood products or non-study hemostatic agents for bleeding control within 24 hours after the end of investigational product infusion., • Number of units of packed red blood cells (PRBCs) administered to achieve bleeding control within 24 hours after the end of investigational product infusion., • Occurrence of serious adverse events (SAEs), and/or adverse events (AEs), treatment emergent AEs (TEAEs), and adverse events of special interest (AESIs) within 30 days after the end of the surgery/invasive procedure., • Occurrence of thrombotic events within 30 days after the end of the surgery/invasive procedure., • All-cause deaths within 30 days post-surgery/invasive procedure.

Source: https://euclinicaltrials.eu/ctis-public/view/2022-503012-16-00